EU clinical trial 2022-502584-38-00: A double-blind randomized, Phase III study of radiotherapy combined with cetuXimab + Xevinapant compared to radiotherapy combined with cetuximab (Standard of care) + placebo in patients with Locally advanced (LA) squamous cell carcinoma of the head and neck (SCCHN), unfit for high-dose cisplatin (XXL study)
Protocol code: GORTEC-2022-01
Sponsor: Groupe Oncologie Radiotherapie Tete Cou (Patient organisation/association). Phase: Therapeutic confirmatory (Phase III). Countries: France (ended).
Therapeutic area(s): Diseases [C] - Pathological Conditions, Signs and Symptoms [C23]; Diseases [C] - Neoplasms [C04]
Gender: Female, Male. Age: 18-64 years, 65+ years. Enrolment: 377.
Status: Ended. Start date (EU): 2023-12-12. End date (EU): 2024-09-30. Decision date: 2023-08-08. Results received: Yes. Last updated: 2024-02-14.

Condition(s): Locally advanced squamous cell carcinoma of the head and neck
Product: xevinapant, Erbitux 5 mg/mL solution for infusion, xevinapant placebo

Primary endpoint: PFS as assessed by independent review committee (IRC) defined as the time from randomization to the first occurrence of any of the following events: death from any cause, disease progression (PD), primary treatment failure before achieving a complete response (CR) or any radiological or clinical relapse after achieving a CR
Endpoint(s): OS, main secondary endpoint, defined as the time from date of randomization to the date of death. Patients last known to be alive will be censored at date of last contact., Progression-free survival by investigator assessment., Compliance will be reported: for radiotherapy (tumor dose, number of fractions, duration and major deviations), for xevinapant/placebo, cetuximab (number of cycles, dose, duration, dose intensity and relative dose intensity). Whatever the treatment, treatment interruption, reduction and discontinuation and their reasons will be reported, Occurrence of adverse events (AEs) and treatment-related AEs.

Source: https://euclinicaltrials.eu/ctis-public/view/2022-502584-38-00